EU clinical trial 2024-511862-35-00: First-line Chemotherapy With Temozolomide Alone for Non-enhancing Adult Brainstem Gliomas, With a Diffuse Subtype and Showing Clinical and/or Radiological Infiltrative Pattern of Progression (TEMOTRAD01)
Protocol code: P160954J
Sponsor: Assistance Publique Hopitaux De Paris (Hospital/Clinic/Other health care facility). Phase: Therapeutic exploratory (Phase II). Countries: France (ongoing, recruiting).
Therapeutic area(s): Diseases [C] - Nervous System Diseases [C10]
Gender: Female, Male. Age: 18-64 years, 65+ years. Enrolment: 60.
Status: Ongoing, recruiting. Start date (EU): 2019-07-19. Decision date: 2024-08-01. Results received: No. Last updated: 2025-10-08.

Condition(s): Adults with non-contrast-enhancing diffuse brainstem gliomas with non-threatening infiltrative clinical and/or radiological progression, Adult brain stem gliomas

Source: https://euclinicaltrials.eu/ctis-public/view/2024-511862-35-00